EU clinical trial 2024-517240-62-00: Dosimetry based PRRT versus standard dose PRRT with Lu-177-DOTATOC in NEN patients- a randomized study; a step towards tailored PRRT.
Sponsor: Region Midtjylland (Hospital/Clinic/Other health care facility). Phase: Therapeutic exploratory (Phase II). Countries: Denmark (ongoing, recruiting).
Therapeutic area(s): Diseases [C] - Neoplasms [C04]
Gender: Female, Male. Age: 18-64 years, 65+ years. Enrolment: 100.
Status: Ongoing, recruiting. Start date (EU): 2024-11-04. Decision date: 2024-11-04. Results received: No. Last updated: 2024-11-04.

Condition(s): Neuroendocrine Tumor
Product: 177Lu-DOTATOC

Primary endpoint: • Difference in progression free survival between NEN patients treated with dosimetry based versus standard PRRT. Defined as time from randomization to documented disease progression or death by any cause, evaluated by CT, RECIST 1.1.
Endpoint(s): • Difference in tumor dose between dosimetry based and standard PRRT treatment groups • Difference in kidney toxicity between dosimetry based and standard PRRT treatment groups, measured by creatine, eGFR, cystatin-c, Tc-DTPA clearance, and kidney fibrosis markers PRO-6, C3M and LAMC1. • Difference in bone marrow function between dosimetry based and standard PRRT treatment groups, measured by hemoglobin, white blood cells, platelets. • Difference in subjective side effects between dosimetry bas

Source: https://euclinicaltrials.eu/ctis-public/view/2024-517240-62-00